EU clinical trial 2023-505347-38-00: Phase 1b/2, Open-Label Study to Evaluate Safety and Tolerability of Epcoritamab in Combination with Anti-Neoplastic Agents in Subjects with Non-Hodgkin Lymphoma
Protocol code: M22-132
Sponsor: AbbVie Deutschland GmbH & Co. KG (Pharmaceutical company). Phase: Phase I and Phase II (Integrated)- Other. Countries: France (ongoing, recruitment ended), Netherlands (ongoing, recruitment ended), Hungary (ongoing, recruitment ended), Czechia (ongoing, recruitment ended), Germany (ongoing, recruitment ended), Spain (ongoing, recruitment ended), Denmark (ongoing, recruitment ended).
Therapeutic area(s): Diseases [C] - Neoplasms [C04]
Gender: Female, Male. Age: 18-64 years. Enrolment: 59.
Status: Ongoing, recruitment ended. Start date (EU): 2022-06-13. Decision date: 2024-02-05. Results received: No. Last updated: 2026-07-27.
Decision dates by country: FR: 2024-02-19, DE: 2024-02-12, NL: 2024-02-06, CZ: 2024-02-06, ES: 2024-02-05, DK: 2024-02-05, HU: 2024-02-05

Condition(s): B-cell Non-Hodgkin's lymphoma, diffuse large B-cell lymphoma
Product: Golcadomide, Venetoclax, Decortin® H 5 mg Tabletten, Revlimid 20 mg hard capsules, Revlimid 25 mg hard capsules, Epcoritamab (GEN3013), Venetoclax, Epcoritamab (GEN3013), Revlimid 10 mg hard capsules, Adriblastin® 50 mg Stechampulle, Cyclophosphamide Injection 500 mg., IMBRUVICA 140 mg hard capsules, Revlimid 5 mg hard capsules, Truxima 500 mg concentrate for solution for infusion, PIRTOBRUTINIB, Polivy 30 mg powder for concentrate for solution for infusion., Venetoclax, Truxima 100 mg concentrate for solution for infusion, IMBRUVICA 140 mg hard capsules, Decortin® H 20 mg Tabletten

Primary endpoint: The primary endpoint is DLTs of epcoritamab in combination with antineoplastic agents.
Endpoint(s): Best overall response (BOR) by Lugano 2014 criteria as assessed by investigator for epcoritamab in combination with other antineoplastic agents., Antilymphoma activity of epcoritamab in combination with other antineoplastic agents: - Duration of response determined per Lugano 2014 criteria as assessed by investigator. - Progression free survival determined per Lugano 2014 criteria as assessed by investigator. - Complete response during the study determined per Lugano 2014 criteria as assessed by investigator. - Time to response determined per Lugano 2014 criteria as assessed by investigator. - Time to next antilymphoma therapy.

Source: https://euclinicaltrials.eu/ctis-public/view/2023-505347-38-00